EU clinical trial 2024-514122-23-00: Phase II trial of acalabrutinib in combination with tafasitamab in patients with previously treated marginal zone lymphomas (MZL)
Sponsor: Association International Extranodal Lymphoma Study Group (IELSG) (Laboratory/Research/Testing facility). Phase: Therapeutic exploratory (Phase II). Countries: Italy (ongoing, recruitment ended), Austria (ongoing, recruitment ended).
Therapeutic area(s): Diseases [C] - Neoplasms [C04]
Gender: Female, Male. Age: 18-64 years, 65+ years. Enrolment: 22.
Status: Ongoing, recruitment ended. Start date (EU): 2021-10-07. Decision date: 2024-07-22. Results received: No. Last updated: 2026-06-18.
Decision dates by country: AT: 2024-07-22, IT: 2024-07-22

Condition(s): Marginal Zone Lymphomas refractory to or in first or greater relapse after prior systemic therapy
Product: MINJUVI 200 mg powder for concentrate for solution for infusion, Calquence 100 mg hard capsules

Primary endpoint: Complete response rate (CR) as best response to treatment, defined according to the international Revised Response Criteria for Malignant Lymphoma . For patients with SMZL, response is defined according to Matutes et al. 2008 and for patients with gastric lymphomas, histological response is evaluated according to GELA scoring system
Endpoint(s): Adverse events type and severity according to CTCAE v5.0 and relationship to study treatment, Overall response rate (ORR), Progression free survival (PFS), Duration of response (DOR), Overall survival (OS)

Source: https://euclinicaltrials.eu/ctis-public/view/2024-514122-23-00